EU clinical trial 2023-504363-17-00: A phase 1/1b/2 study evaluating the safety, tolerability, pharmacokinetics, pharmacodynamics, and efficacy of AMG 193 alone and in combination with docetaxel in subjects with advanced MTAP-null solid tumors
Protocol code: 20210023
Sponsor: Amgen Inc. (Pharmaceutical company). Phase: Phase I and Phase II (Integrated)- First administration to humans. Countries: Belgium (ended), Germany (ended), Austria (ended), France (ended).
Therapeutic area(s): Diseases [C] - Neoplasms [C04]
Gender: Female, Male. Age: 18-64 years, 65+ years. Enrolment: 98.
Status: Ended. Start date (EU): 2022-05-13. End date (EU): 2026-06-10. Decision date: 2024-08-22. Results received: No. Last updated: 2026-05-27.
Decision dates by country: FR: 2024-09-05, BE: 2024-08-22, DE: 2024-09-13, AT: 2024-09-02

Condition(s): Advanced MTAP-null solid tumors
Product: AMG 193, AMG 193, AMG 193

Primary endpoint: Part 1 and 2: DLTs, treatment-emergent adverse events, serious adverse events, and changes in vital signs, ECGs, and clinical laboratory tests., Part 3: Objective response (defined as best overall response of confirmed CR or PR based on RECIST v1.1) derived utilizing investigator tumor assessments.
Endpoint(s): Part 1 and 2: PK parameters of AMG 193 alone and in combination with docetaxel., PK parameters of docetaxel (Parts 2a and 2b only) in combination with AMG 193 after multiple doses., Part 1 and 2 Objective response (defined as the best overall response of confirmed CR or PR based on RECIST v1.1), Disease Control (DC), Duration of Response (DoR), Duration of disease control (DoDC), Time to Response (TTR), Overall Survival (OS), Progression-Free Survival (PFS)

Source: https://euclinicaltrials.eu/ctis-public/view/2023-504363-17-00